EU clinical trial 2023-504420-26-00: An open label, single-arm, phase 2 study of perioperative sacituzumab govitecan in combination with zimberelimab and domvanalimab for patients with muscle invasive bladder cancer ineligible for cisplatin-based chemotherapy. (PeRioperative Immunotherapy combined with Sacituzumab govitecan in Muscle invasive blAdder cancer)
Protocol code: FUP415002 / PRISMA-1
Sponsor: Fundacion Para El Progreso De La Oncologia En Cantabria (Hospital/Clinic/Other health care facility). Phase: Therapeutic exploratory (Phase II). Countries: Spain (ongoing, recruitment ended).
Therapeutic area(s): Diseases [C] - Female Urogenital Diseases and Pregnancy Complications [C13]; Diseases [C] - Neoplasms [C04]; Diseases [C] - Male Urogenital Diseases [C12]
Gender: Female, Male. Age: 18-64 years, 65+ years. Enrolment: 70.
Status: Ongoing, recruitment ended. Start date (EU): 2025-01-13. Decision date: 2024-02-21. Results received: No. Last updated: 2026-07-16.

Condition(s): Bladder Cancer
Product: Zimberelimab, Domvanalimab, Trodelvy 200 mg powder for concentrate for solution for infusion

Primary endpoint: Efficacy of the combination of sacituzumab govitecan, zimberelimab and domvanalimab measured as pathologic complete response (pCR) rates. pCR is defined as absence of residual viable tumor (ypT0) in the radical cystectomy specimen and in the resected lymph nodes (ypN0) (posttreatment).
Endpoint(s): Efficacy of the combination of sacituzumab govitecan, zimberelimab and domvanalimab measured as the downstaging rates after neoadjuvant treatment. Downstaging is defined as any non-muscle invasive residual disease after treatment in the cystectomy specimen (i.e ypTis, ypTa, ypT1)., Efficacy of neoadjuvant sacituzumab govitecan, zimberelimab and domvanalimab with respect to anti-tumor effects based on investigator assessed disease free survival (DFS). DFS event is defined as any of the following: development of distant metastasis of bladder carcinoma or presence of pelvic recurrence of bladder carcinoma (including soft tissue and regional lymph nodes) or death from any cause, Efficacy of neoadjuvant sacituzumab govitecan, zimberelimab and domvanalimab with respect to anti-tumor effects based on overall survival (OS). OS is defined as the time from informed consent signature to death from any cause., Safety and tolerability of the combination of sacituzumab govitecan, zimberelimab and domvanalimab measured as the incidence, nature and severity of adverse events (AEs)., Number of patients undergoing cystectomy later than 12 weeks after the last dose of sacituzumab govitecan, zimberelimab and domvanalimab treatment in the pre-operative setting., Cancer associated fibroblast (CAFs) as predictors of response. The differences in CAFs clusters (i.e. subpopulations) will be measured by scRNA seq and signatures analysis in responders vs non-responders, and assessed in combination with other clinical and molecular characteristics., Immune sub-populations as predictors of response, ctDNA as a predictor of benefit and marker of relapse.a. ct DNA levels will be measured at baseline, at the end of the neoadjuvant treatment before the cystectomy, after the cystectomy [at the beginning of the adjuvant phase], at the completion of the adjuvant treatment in the cohort assigned to this therapy, and thereafter every three months during follow-up visits for the first year (at weeks 16, 28, 40 and 52) in patients with pCR and negative ctDNA., Efficacy of adjuvant zimberelimab and domvanalimab in a selected population [not pCR and/or +ctDNA] with respect to anti-tumor effects based on investigator assessed disease free survival (DFS). DFS event is defined as any of the following: development of distant metastasis of bladder carcinoma or presence of pelvic recurrence of urothelial carcinoma (including soft tissue and regional lymph nodes) or death from any cause., Efficacy of adjuvant zimberelimab and domvanalimab in a selected population [not pCR and/or +ctDNA] with respect to anti-tumor effects based on overall survival (OS). OS is defined as the time from informed consent signature to death from any cause.

Source: https://euclinicaltrials.eu/ctis-public/view/2023-504420-26-00